EU clinical trial 2023-503294-37-00: A Phase 3, Open-Label, Multicenter, Randomized Study to evaluate the Efficacy and Safety of Romosozumab Compared with Bisphophonates in Children and Adolecents with Osteogenesis Imperfecta
Protocol code: 20200105
Sponsor: Amgen Inc. (Pharmaceutical company). Phase: Therapeutic confirmatory (Phase III). Countries: Slovakia (ended), Germany (ongoing, recruitment ended), Belgium (ongoing, recruitment ended), Spain (ongoing, recruitment ended), Hungary (ongoing, recruitment ended), Austria (ongoing, recruitment ended), France (ongoing, recruitment ended), Poland (ongoing, recruitment ended), Italy (ongoing, recruitment ended).
Therapeutic area(s): Diseases [C] - Musculoskeletal Diseases [C05]; Diseases [C] - Skin and Connective Tissue Diseases [C17]; Diseases [C] - Congenital, Hereditary, and Neonatal Diseases and Abnormalities [C16]
Gender: Female, Male. Age: 0-17 years. Enrolment: 51.
Start date (EU): 2023-11-20. Decision date: 2023-10-02. Results received: No. Last updated: 2026-03-27.
Decision dates by country: ES: 2023-10-04, DE: 2023-10-05, BE: 2023-10-03, SK: 2023-10-02, HU: 2023-10-04, AT: 2023-10-09, FR: 2023-10-09, IT: 2025-11-28, PL: 2023-10-09

Condition(s): Osteogenesis Imperfecta
Product: EVENITY 105 mg solution for injection in pre-filled pen, ERGOCALCIFEROL, EVENITY 105 mg solution for injection in pre-filled pen, CALCIUM, EVENITY 105 mg solution for injection in pre-filled syringe, EVENITY 105 mg solution for injection in pre-filled syringe

Primary endpoint: Number of clinical fractures (clinical vertebral fractures and nonvertebral) through Month 12, Number of any fractures (new and worsening vertebral compression fractures, whether clinically silent or manifest, and nonvertebral) through Month 12, Change from baseline in lumbar spine BMD Z-score at Month 12, as assessed by DXA
Endpoint(s): Change from baseline in lumbar spine BMD Z score at Month 12 (this is not a secondary endpoint for the EMA as it is already listed as one of the primary endpoints), Change from baseline in total hip BMD Z score at Month 12, as assessed by DXA, Change from baseline in femoral neck BMD Z score at Month 12, as assessed by DXA, •Subject incidence of nonvertebral fractures through month 12 •Subject incidence of long bone fractures through month 12 •Number of new or worsening vertebral fractures through Month 12 •Number of nonvertebral fractures through Month 12 •Number of long bone fractures through Month 12, Change from baseline in CHQ-PF-50 Physical Summary score, CHAQ-CV disability score and Wong-Baker Faces Pain Rating, Serum concentration of romosozumab at Day 1, Month 6, and Month 12

Source: https://euclinicaltrials.eu/ctis-public/view/2023-503294-37-00